EU clinical trial 2024-518236-36-00: Efficacy and safety of adjuvant peptide receptor radionuclide therapy after curative surgery of locoregional limited small intestine neuroendocrine neoplasia – a multi-center, prospective, open-label, two-arm parallel group, randomized, controlled, phase III study
Protocol code: KKS-312
Sponsor: Philipps-Universitaet Marburg (Educational Institution). Phase: Therapeutic confirmatory (Phase III). Countries: Germany (ongoing, recruiting).
Therapeutic area(s): Diseases [C] - Neoplasms [C04]; Diseases [C] - Digestive System Diseases [C06]; Diseases [C] - Hormonal diseases [C19]
Gender: Female, Male. Age: 18-64 years, 65+ years. Enrolment: 160.
Status: Ongoing, recruiting. Start date (EU): 2026-03-12. Decision date: 2025-07-14. Results received: No. Last updated: 2026-04-15.

Condition(s): Locoregionally restricted (stage III) small intestinal neuroendocrine neoplasms (SI-NEN)
Product: Lutathera 370 MBq/mL solution for infusion

Primary endpoint: RFS will be defined as the time from randomization to first relapse or death, whichever occurs earlier (acc. to ENETS guidelines). Relapse is defined as newly detected lesion with SSTR uptake in PET-CT.
Endpoint(s): Overall Survival (OS) and cancer-specific OS will be defined as the time from randomization to death/ cancer-specific death., AEs/SAEs, HRQOL will be measured by means of EORTC QLQ-C30/ GINET21 questionnaires.

Source: https://euclinicaltrials.eu/ctis-public/view/2024-518236-36-00